EU clinical trial 2023-508663-70-00: A randomized, double-blind, placebo-controlled, parallel-group, Proof-of-Concept (PoC) study to assess the efficacy, safety and tolerability of itepekimab, in participants with non-cystic fibrosis bronchiectasis
Protocol code: ACT18018
Sponsor: Sanofi-Aventis Recherche & Developpement (Pharmaceutical company). Phase: Therapeutic exploratory (Phase II). Countries: Italy (ended), Czechia (ended), Spain (ended), Denmark (ended), Netherlands (ended), France (ended), Greece (ended), Poland (ended), Germany (ended).
Therapeutic area(s): Diseases [C] - Respiratory Tract Diseases [C08]
Gender: Female, Male. Age: 18-64 years, 65+ years. Enrolment: 138.
Status: Ended. Start date (EU): 2024-06-18. End date (EU): 2026-02-02. End date: 2026-02-03. Decision date: 2024-05-29. Results received: No. Last updated: 2026-01-21.
Decision dates by country: CZ: 2024-05-29, DE: 2024-06-03, DK: 2024-05-29, ES: 2024-05-30, FR: 2024-05-29, GR: 2024-06-03, IT: 2024-05-29, NL: 2024-05-31, PL: 2024-06-03

Condition(s): Bronchiectasis
Product: Itepekimab, Matched placebo for test product

Primary endpoint: Annualized rate of moderate or severe Pulmonary exacerbations (PEs) over the treatment period
Endpoint(s): Time to first moderate or severe PE over the treatment period, Percentage of participants who are PE free over the treatment period, Annualized rate of severe PEs over the treatment period, Percentage of participants who are severe PE free over the treatment period, Time to first severe PE over the treatment period, Change From Baseline in FEV1 at Week 8 and Week 24, Number of days of new and/or added (in participants with maintenance antibiotic use) antibiotic use, Change from Baseline in QOL-B Respiratory Symptoms Domain Score in Adult Participants at Week 24, Change from baseline in SGRQ total score at Week 24, Percentage of participants with a decrease from baseline of at least 4 points in SGRQ total score at Week 24, Incidence of TEAEs, AESIs, SAEs, and AEs leading to permanent study treatment discontinuation in the treatment-emergent period, Serum concentrations of itepekimab from baseline to end of study, Incidence of treatment-emergent anti-itepekimab antibodies (ADA) responses throughout the study

Source: https://euclinicaltrials.eu/ctis-public/view/2023-508663-70-00